EU clinical trial 2024-517888-23-00: Model-informed precision dosing for linezolid: a randomized clinical trial
Protocol code: ZKSJ0160_LineMAP
Sponsor: University Medical Center Hamburg-Eppendorf (Hospital/Clinic/Other health care facility). Phase: Therapeutic confirmatory (Phase III). Countries: Germany (authorised, recruitment pending).
Therapeutic area(s): Diseases [C] - Bacterial Infections and Mycoses [C01]
Gender: Female, Male. Age: 18-64 years, 65+ years. Enrolment: 30.
Status: Authorised, recruitment pending. Decision date: 2026-07-13. Results received: No. Last updated: 2026-07-13.

Condition(s): Bacterial infection (pneumonia, skin or soft tissue infection) requiring treatment with linezolid in patients in intensive care unit
Product: LINEZOLID

Primary endpoint: The primary endpoint is defined as the achievement of a trough linezolid concentration within the range of 2 to 8 mg/L on Day 7, where concentrations within this range will be considered a success, and concentrations below 2 mg/L or above 8 mg/L will be considered a failure. Also, patients for whom a TDM sample is not obtained on Day 7 will be considered as failures.
Endpoint(s): Likelihood of maintaining a trough linezolid concentration between 2 to 8 mg/L on Day 13, Pharmacokinetic: -Investigation of differences in the occurrence of certain AES (elevated lactate (> 2 mmol/L), thrombocytopenia (<150/µL)), Toxicity: - comparison between the mean of platelets count among both groups (for each day) after the start up to end of linezolid treatment for the control group and after the first adapted dose by TDMx up to the end of linezolid treatment for the intervention group, Toxicity: - comparison between the mean of lactates among both groups (for each day) after the start up to end of linezolid treatment for the control group and after the first adapted dose by TDMx up to the end of linezolid treatment for the intervention group, Toxicity: - proportion of patients with peripheral neuropathy among both groups, Microbiological: - proportion of patients with rectal/nasal/inguinal carriage of gram-positive bacteria resistant to linezolid among both groups acquired from the Baseline and the EOT up to EOF, Microbiological: - proportion of patients achieving microbiological eradication (sterilization of blood cultures or the biological material previously infected) of gram-positive bacteria identified at the beginning of linezolid treatment among both groups, if applicable, Microbiological: - proportion of relapse (growth of the same gram-positive organism in the blood culture or in another primarily site infected up to EOF after microbiological eradication) episode among the two groups, -Comparison of mean Overall duration of linezolid infusion among two arms, -Median length of ICU stays since the first linezolid infusion up to EOF, -Median length of hospital stays since the first linezolid infusion up to EOF, -all cause ICU mortality up to EOF (respectively for the modified Intention-to-treat (mITT) population and all randomized patients), -all cause hospital mortality up to EOF (respectively for the mITT population and all randomized patients), -Incidence of SAEs

Source: https://euclinicaltrials.eu/ctis-public/view/2024-517888-23-00